EU clinical trial 2023-505380-36-01: Randomized, double-blind, Placebo-controlled, 2x2 cross over study assessing the efficacy and safety of cANnabidiol oral solution for joint pain of adjuvant enDOcrine theRApy in patients with early breast cancer (PANDORA)
Protocol code: CSET 2021/3373
Sponsor: Institut Gustave Roussy (Hospital/Clinic/Other health care facility). Phase: Therapeutic confirmatory (Phase III). Countries: France (authorised, recruitment pending).
Therapeutic area(s): Not possible to specify
Gender: Female, Male. Age: 18-64 years, 65+ years. Enrolment: 130.
Status: Authorised, recruitment pending. Decision date: 2024-09-09. Results received: No. Last updated: 2026-08-06.

Condition(s): Patients with stage I, II, III hormone-receptor positive (HR+) breast cancer (BC) receiving adjuvant aromatase inhibitors (AI) and presenting AI-related musculoskeletal pain (reported average joint pain score of ≥ 4 out of 10 on the Brief Pain Inventory)
Product: caprylic/capric triglyceride liquid, LGP PURE CBD 200

Primary endpoint: The primary endpoint is efficacy of CBD on AI-associated pain, measured by the BPI-SF. A one-point difference in BPI average joint pain is considered a minimal important difference and clinically meaningful
Endpoint(s): Articular function, stiffness and pain of knees and hips as measured by the Western Ontario and McMaster Universities Osteoarthritis scale (WOMAC) Qol Qol domains will be assessed using: EORTC QLQ-C30 EORTC QLQ-BR45 (Aaronson et al. 1993; Bjelic-Radisic et al. 2020), and the fatigue subscale EORTC QLQ-FA12, Anxiety and depression. Anxiety and depression will be assessed using the Hospital Anxiety and Depression Scale (HADS), Adherence : patient’s self-reporting through the questionnaire MIS (medication intake survey), collected at baseline and weeks 4, 12, 13, 17, 25 and 37, Safety. A trained research nurse will collect side effects measured by CTCAE V.5. An adverse event (AE) is defined as any untoward medical occurrence, in a patient or clinical trial subject treated by a medicinal product and which does not necessarily have a causal relationship with this treatment. The AE collected will be particularly focused on nausea, constipation, cognitive dysfunction, nervous system and psychiatric side effects. Drug consumption and Hospitalizations associated with nervous system and psychiatric disorders, Risk-taking behavior. Information on risk perception and attitude in risk-taking situations will be evaluated with the DOSPERT (Domain-Specific Risk-Taking) scale., Daily pain medication consumption for muskuloskeletal symptoms collected through a daily diary filled in by each participant, Drug addiction will be assessed using the CAST questionnaire

Source: https://euclinicaltrials.eu/ctis-public/view/2023-505380-36-01